EU clinical trial 2023-506578-11-00: Subcutaneous Methotrexate, Oral Dexamethasone or Oral Montelukast for the Prevention of Infusion Related Reaction Associated with Amivantamab, an EGFR-MET bispecific antibody, Among Post-osimertinib Treated EGFRm NSCLC; SKIPPirr, a Phase 2 Study
Protocol code: 61186372NSC2005
Sponsor: Janssen - Cilag International (Pharmaceutical company). Phase: Therapeutic exploratory (Phase II). Countries: France (ended), Spain (ended).
Therapeutic area(s): Diseases [C] - Neoplasms [C04]
Gender: Female, Male. Age: 18-64 years, 65+ years. Enrolment: 60.
Status: Ended. Start date (EU): 2023-04-25. End date (EU): 2026-02-09. Decision date: 2024-01-31. Results received: No. Last updated: 2026-02-17.
Decision dates by country: FR: 2024-02-13, ES: 2024-05-08

Condition(s): EGFR-mutated Advanced or Metastatic Non-small Cell Lung Cancer
Product: JNJ-73841937, Montelukast Sodium Tablets, Dexamethason 4 mg JENAPHARM®, Methotrexat-Ebewe, 10mg/ml, roztwór do wstrzykiwań, JNJ-61186372, Methotrexate

Primary endpoint: Rate of IRRs occurring on Cycle 1 Day 1 following administration of oral lazertinib and IV amivantamab combination therapy, which is defined as IRR events with onset time within 24 hours of the start of the first amivantamab infusion and prior to the start of amivantamab infusion on Cycle 1 Day 2.

Source: https://euclinicaltrials.eu/ctis-public/view/2023-506578-11-00